EU clinical trial 2023-508459-37-00: A clinical trial to look at how ZN-A-1041 alone or ZN-A-1041 plus some approved drugs works to reduce tumor size and how safe these drugs are at different doses.
Protocol code: XO45189
Sponsor: F. Hoffmann-La Roche AG (Pharmaceutical company). Phase: Human Pharmacology (Phase I)- First administration to humans. Countries: France (ongoing, recruitment ended), Spain (ongoing, recruitment ended), Italy (ongoing, recruitment ended).
Therapeutic area(s): Diseases [C] - Neoplasms [C04]
Gender: Female, Male. Age: 18-64 years, 65+ years. Enrolment: 34.
Status: Ongoing, recruitment ended. Start date (EU): 2024-05-28. Decision date: 2024-04-23. Results received: No. Last updated: 2025-12-08.
Decision dates by country: FR: 2024-04-29, ES: 2024-04-23, IT: 2025-05-21

Condition(s): HER2-positive advanced solid tumours

Source: https://euclinicaltrials.eu/ctis-public/view/2023-508459-37-00